EU clinical trial 2024-519217-64-00: SubSUF-ER - Management of moderate to severe monotraumatic pain with sublingual Sufentanil in an emergency situation.
Protocol code: RBHP 2024 MOUSTAFA
Sponsor: University Hospital Of Clermont-Ferrand (Hospital/Clinic/Other health care facility). Phase: Therapeutic use (Phase IV). Countries: France (ongoing, recruiting).
Therapeutic area(s): Analytical, Diagnostic and Therapeutic Techniques and Equipment [E] - Anesthesia and Analgesia [E03]; Diseases [C] - Musculoskeletal Diseases [C05]
Gender: Female, Male. Age: 18-64 years, 65+ years. Enrolment: 300.
Status: Ongoing, recruiting. Start date (EU): 2025-04-22. Decision date: 2025-03-21. Results received: No. Last updated: 2026-04-24.

Condition(s): trauma to the lower or upper limb
Product: IXPRIM 37,5 mg/325 mg, comprimé pelliculé, Dzuveo 30 micrograms sublingual tablet, DOLIPRANE 1000 mg, gélule, ACUPAN 20 mg/2 mL, solution injectable, DOLIPRANE 500 mg, comprimé, KALINOX 50 %/ 50 % Gas zur medizinischen Anwendung, druckverdichtet, TRAMADOL ARROW 100 mg/2 mL, solution injectable/pour perfusion, KETOPROFENE AGUETTANT 100 mg, solution pour perfusion, PARACETAMOL AGUETTANT 10 mg/ml, solution pour perfusion, MORPHINE (CHLORHYDRATE) RENAUDIN 10 mg/ml, solution injectable, CODOLIPRANE 500 mg/30 mg, comprimé

Primary endpoint: the variation in pain rating measured by the verbal numerical scale between T0 and T0+60 minutes
Endpoint(s): The tolerance profile will be assessed by analyzing the occurrence of any adverse event, mainly (hypotension, bradycardia, respiratory depression, sweating, drowsiness, nausea and/or vomiting, dizziness), Variation of pain rating measured by verbal numerical scale between T0 and T0+15min; T0+30 min; T0+45 min; T0 + 60 min T0+120 min; T0+180 minutes, Variation of pain rating measured by verbal numerical scale between T0 and TEVmax. Pain intensity assessed at different times, T0, T0 + 15min, T0 + 30min, T0 + 45min, T0 + 60min, T0 + 120min, T0 + 180min., Measurement of variations in hemodynamic parameters: blood pressure, pulse, oxygen saturation, respiratory rate., At the end of the study at T0 + 180 min, patients will be asked to give their assessment via a verbal satisfaction scale ranging from 0 "Very dissatisfied" to 10 "Very satisfied": - of the permucosal product tested using a product assessment questionnaire. - Of the pain management in general

Source: https://euclinicaltrials.eu/ctis-public/view/2024-519217-64-00